EU clinical trial 2023-505107-24-00: A Phase 1/2 Study of Avutometinib (VS-6766) in Combination with Sotorasib in Patients with KRAS G12C mutant Non-Small Cell Lung Cancer (NSCLC) (RAMP 203)
Protocol code: VS-6766-203
Sponsor: Verastem Inc. (Pharmaceutical company). Phase: Phase I and Phase II (Integrated)- Other. Countries: France (ended), Spain (ongoing, recruitment ended), Netherlands (ongoing, recruitment ended), Belgium (ongoing, recruitment ended).
Therapeutic area(s): Diseases [C] - Cardiovascular Diseases [C14]
Gender: Female, Male. Age: 18-64 years, 65+ years. Enrolment: 48.
Start date (EU): 2023-11-14. Decision date: 2023-11-03. Results received: No. Last updated: 2026-04-15.
Decision dates by country: NL: 2023-11-03, ES: 2023-11-07, BE: 2023-11-08, FR: 2023-11-08

Condition(s): Non-small cell lung cancer
Product: LUMYKRAS 120 mg film-coated tablets, VS-6766, VS-6063

Primary endpoint: Part A Dose Evaluation: Dose-limiting toxicities (DLTs), adverse events (AEs), serious AEs (s), physical examinations, clinical laboratory values, and tolerability (dose interruptions/reductions). -Part B Dose Expansion: Confirmed ORR (partial response [PR] + complete response [CR] defined according to Response Evaluation Criteria in Solid Tumors version 1.1 [RECIST 1.1])
Endpoint(s): Adverse events, SAEs, physical examinations, clinical laboratory values, and tolerability (dose interruptions/reductions)., Duration of response (DOR), Disease control rate (DCR), defined as Complete response (CR) + Partial response (PR) + Stable disease (SD), Clinical benefit rate (CBR), defined as complete response (CR) + partial response (PR) + stable disease (SD) ≥ 6 months, Progression-free survival (PFS) defined as the time from first dose of study treatment to the first documentation of progressive disease (PD), or death from any cause, Overall survival (OS), PK parameters derived from plasma concentrations of avutometinib, sotorasib, defactinib, and relevant metabolites

Source: https://euclinicaltrials.eu/ctis-public/view/2023-505107-24-00